EU clinical trial 2025-521431-37-00: First-in-Human Study of ALN-SNCA in Adult Participants with Early Parkinson’s Disease (PD)
Protocol code: ALN-SNCA-PD-2482
Sponsor: Regeneron Pharmaceuticals Inc. (Pharmaceutical company). Phase: Human Pharmacology (Phase I)- First administration to humans. Countries: Netherlands (ongoing, recruiting).
Therapeutic area(s): Diseases [C] - Nervous System Diseases [C10]
Gender: Female, Male. Age: 18-64 years, 65+ years. Enrolment: 23.
Status: Ongoing, recruiting. Start date (EU): 2025-11-20. Decision date: 2025-11-17. Results received: No. Last updated: 2026-07-17.

Condition(s): Parkinson's disease

Source: https://euclinicaltrials.eu/ctis-public/view/2025-521431-37-00